EU clinical trial 2024-512487-61-00: Effects of calcium electroporation, electrochemotherapy, and irreversible electroporation (IRE-CaCl2, ECT and IRE) on quality of life and progression – free survival in patients with pancreatic cancer" (IREC).
Protocol code: 2020/ABM/01/00098
Sponsor: Wroclaw Medical University (Educational Institution). Phase: Therapeutic confirmatory (Phase III). Countries: Poland (ongoing, recruitment ended).
Therapeutic area(s): Diseases [C] - Neoplasms [C04]
Gender: Female, Male. Age: 18-64 years, 65+ years. Enrolment: 73.
Status: Ongoing, recruitment ended. Start date (EU): 2022-02-10. Decision date: 2024-08-09. Results received: No. Last updated: 2024-08-09.

Condition(s): Unresectable pancreatic cancer
Product: CALCIUM CHLORATUM WZF, 67 mg/ml, roztwór do wstrzykiwań, Bleomedac 15000 IU (wg Farmakopei Europejskiej) = 15 U (wg Farmakopei Amerykańskiej)/fiolkę, proszek do sporządzania roztworu do wstrzykiwań

Primary endpoint: Progression-free survival (PFS) defined as the time from initiation of study treatment to the first occurrence of disease progression or death from any cause, whichever occurs first.
Endpoint(s): Patient overall survival (OS) defined as the proportion of patients remaining alive from the initiation of study treatment until the last follow-up visit., Body weight change in predefined timepoints, Pain level (VAS scale), Quality of life EORTC QLQ-PAN26 and WHOQOL-BREF, Exploratory endpoints: 1. Levels of biomarkers (Ca 19-9 in 1,4, 6 days after surgery [+/- 1 day] and during standard follow-up visits) 2. Changes in morphology and biochemistry panel (including but not limited to, albumin, protein, lipase, amylase levels, CRP, procalcitonin) at the timepoints described by schedule of assessments. 3. Progression-free survival (PFS) defined as the time from the diagnosis

Source: https://euclinicaltrials.eu/ctis-public/view/2024-512487-61-00